EU clinical trial 2023-504092-25-00: A Randomised, Double-Blind, Placebo Controlled, Two-Part Study to Evaluate the Efficacy, Safety, Tolerability and Pharmacokinetics of a Repeat Dose of Inhaled ETD001 in People with Cystic Fibrosis
Protocol code: ET-ENAC-03
Sponsor: Enterprise Therapeutics Limited (Pharmaceutical company). Phase: Therapeutic exploratory (Phase II). Countries: Germany (ended), France (ended), Italy (ended).
Therapeutic area(s): Diseases [C] - Respiratory Tract Diseases [C08]
Gender: Female, Male. Age: 18-64 years. Enrolment: 50.
Status: Ended. Start date (EU): 2024-06-04. End date (EU): 2025-11-14. End date: 2025-11-15. Decision date: 2023-12-18. Results received: No. Last updated: 2025-08-11.
Decision dates by country: IT: 2024-08-14, DE: 2023-12-18, FR: 2024-01-15

Condition(s): Cystic Fibrosis
Product: ETD001 Placebo, ETD001C

Primary endpoint: Part A: Incidence of AE, SAE (including death), withdrawals due to AE Part A: Change from baseline in safety assessments (ECG, vital signs, spirometry, clinical laboratory results and physical examination) Part B: Change in ppFEV1 from baseline to Day 28 (for either Treatment Period 1 or Treatment Period 2), compared to placebo
Endpoint(s): Part A: Derived PK parameters in plasma and urine for ETD001 after repeat inhaled dose administration, Relative change in ppFEV1 from baseline to D28, compared to placebo. Absolute change in other lung function endpoints including FVC, FEV1/FVC ratio and FEF25-75 from baseline to D28, compared to placebo.Incidence of AE, SAE (including death), withdrawals due to AE.Change in safety assessments from baseline to D28, compared to placebo.Change in CFQ-R (respiratory domain) from baseline to D28, compared to placebo. Population PK characteristics and model generated individual PK Parameters

Source: https://euclinicaltrials.eu/ctis-public/view/2023-504092-25-00